EU clinical trial 2025-520814-78-00: FIDES: Focused Ultrasound-mediated Blood-Brain Barrier Opening In Pontine Diffuse Midline Glioma (DMG) to Enhance Systemic Therapy with Temozolomide – an exploratory pilot and feasibility trial
Protocol code: 23U-0160
Sponsor: Universitair Medisch Centrum Utrecht (Hospital/Clinic/Other health care facility). Phase: Phase I and Phase II (Integrated)- Other. Countries: Netherlands (authorised, recruitment pending).
Therapeutic area(s): Diseases [C] - Nervous System Diseases [C10]; Diseases [C] - Neoplasms [C04]
Gender: Female, Male. Age: 0-17 years, 18-64 years. Enrolment: 20.
Status: Authorised, recruitment pending. Decision date: 2026-03-23. Results received: No. Last updated: 2026-06-26.
Decision dates by country: NL: 2026-04-07

Condition(s): Diffuse Midline Glioma, H3K27-altered
Product: Temozolomide Accord 100 mg hard capsules., Temozolomide SUN 5 mg hard capsules, Temozolomide SUN 20 mg hard capsules, Temozolomide SUN 180 mg hard capsules, Temozolomide Accord 5 mg hard capsules., Temozolomide SUN 140 mg hard capsules, Temozolomide SUN 250 mg hard capsules, Temozolomide Accord 140 mg hard capsules., Temozolomide SUN 100 mg hard capsules, Temozolomide Accord 250 mg hard capsules., Temozolomide Accord 180 mg hard capsules., Temozolomide Accord 20 mg hard capsules.

Primary endpoint: Any serious adverse events (SAE) related to the Exablate BBBO device- and procedure, classified according to the Common Terminology Criteria for Adverse Events (CTCAE) version 6.0., Proportion of patients alive and progression-free at 6 months, based on standardized imaging criteria (e.g., RANO or RAPNO for DMG).
Endpoint(s): Time from diagnosis to disease progression or death, measured by standardized criteria (e.g., RANO/RAPNO)., Time from diagnosis to death from any cause., Radiological response rate according to the response assessment in neuro-oncology criteria (RANO and RAPNO criteria), Extent and consistency of BBB opening as confirmed by T1-weighted contrast-enhanced MRI after each Exablate BBBO session., Incidence of adverse events (AE) over time related to the Exablate BBBO device- and procedure, classified according to the Common Terminology Criteria for Adverse Events (CTCAE) version 6.0.

Source: https://euclinicaltrials.eu/ctis-public/view/2025-520814-78-00